EU clinical trial 2023-510178-15-00: A Phase 3, Multicenter, Randomized, Double-blind, Placebo-controlled Study Comparing the Efficacy and Safety of Golcadomide Plus R-CHOP Chemotherapy vs Placebo Plus R-CHOP Chemotherapy in Participants with Previously Untreated High-risk Large B-cell Lymphoma (GOLSEEK-1)
Protocol code: CA073-1020
Sponsor: Celgene Corp. (Pharmaceutical company). Phase: Therapeutic confirmatory (Phase III). Countries: Poland (ongoing, recruitment ended), Greece (ongoing, recruitment ended), Hungary (ongoing, recruitment ended), Portugal (ongoing, recruitment ended), Spain (ongoing, recruitment ended), Norway (ongoing, recruitment ended), Finland (ongoing, recruitment ended), Denmark (ongoing, recruitment ended), Austria (ongoing, recruitment ended), Romania (ongoing, recruitment ended), France (ongoing, recruitment ended), Bulgaria (ended), Germany (ongoing, recruitment ended), Czechia (ongoing, recruitment ended), Sweden (ongoing, recruitment ended), Italy (ongoing, recruitment ended), Netherlands (ongoing, recruitment ended).
Therapeutic area(s): Diseases [C] - Hemic and Lymphatic Diseases [C15]
Gender: Female, Male. Age: 18-64 years, 65+ years. Enrolment: 322.
Start date (EU): 2024-07-31. Decision date: 2024-07-15. Results received: No. Last updated: 2026-08-08.
Decision dates by country: BG: 2024-07-22, NO: 2024-07-15, RO: 2024-07-29, PL: 2024-07-22, ES: 2024-07-20, SE: 2024-07-19, DK: 2024-07-16, AT: 2024-07-22, FI: 2024-07-22, IT: 2025-05-12, GR: 2024-07-22, FR: 2024-07-22, DE: 2024-07-16, CZ: 2024-07-17, NL: 2025-04-22, PT: 2024-07-16, HU: 2024-07-16

Condition(s): High-risk Large B-cell Lymphoma
Product: DOXORUBICIN HYDROCHLORIDE, Golcadomide, PREDNISONE, Golcadomide, RITUXIMAB, VINCRISTINE SULFATE, Golcadomide, Golcadomide 0.2 mg capsule, Golcadomide 0.3 mg capsule, Golcadomide 0.4 mg capsule, APIXABAN, VINCRISTINE SULFATE, CYCLOPHOSPHAMIDE MONOHYDRATE, PREDNISOLONE, Neulasta 6 mg solution for injection, RITUXIMAB

Primary endpoint: To evaluate the PFS. This is the time from when a person starts the trial until their disease gets worse or they pass away, whichever happens first.
Endpoint(s): To evaluate the OS. This is the time from when a person starts the trial until they pass away from any cause., To evaluate the EFS. This is the time from when a person starts the trial until one of the following happens: they pass away, their disease gets worse or comes back, they start a new treatment for their lymphoma, or they show signs of disease after finishing the treatment., To evaluate the CMR. This means that at the end of the treatment, the person's disease has completely responded to the treatment., To evaluate the MRD negativity. This means that at the end of the treatment, we can't detect any cancer DNA in the person's body., To evaluate the PFS in participants with IPI score 3-5. This is the time from when a person starts the trial until their disease gets worse or they pass away, whichever happens first., To evaluate the PFS in participants with non-HGBL. This is the time from when a person starts the trial until their disease gets worse or they pass away, whichever happens first.

Source: https://euclinicaltrials.eu/ctis-public/view/2023-510178-15-00